EU clinical trial 2024-514197-50-00: A Phase 1b/2 Study of IMGN632 as Monotherapy or Combination with Venetoclax and/or Azacitidine for Patients with CD123-Positive Acute Myeloid Leukemia
Protocol code: IMGN632-0802
Sponsor: AbbVie Deutschland GmbH & Co. KG (Pharmaceutical company). Phase: Phase I and Phase II (Integrated)- Other. Countries: Spain (ongoing, recruitment ended), Italy (ongoing, recruitment ended), Germany (ended), France (ongoing, recruitment ended).
Therapeutic area(s): Diseases [C] - Neoplasms [C04]
Gender: Female, Male. Age: 18-64 years, 65+ years. Enrolment: 68.
Start date (EU): 2020-01-17. Decision date: 2024-09-02. Results received: No. Last updated: 2026-04-17.
Decision dates by country: DE: 2024-09-06, ES: 2024-09-05, FR: 2024-09-02, IT: 2024-09-09

Condition(s): CD123 positive Acute Myeloid Leukemia
Product: Vidaza 25 mg/ml powder for suspension for injection, Venclyxto 100 mg film-coated tablets, Venclyxto 100 mg film-coated tablets, PIVEKIMAB SUNIRINE, Venclyxto 100 mg film-coated tablets

Primary endpoint: Dose Escalation (Regimens A-C): RP2D of IMGN632 when administered in combination with azacitidine (Regimen A) or venetoclax (Regimen B) or azacitidine + venetoclax (Regimen C)., Dose Escalation (Regimens A-C): Treatment-emergent adverse events (TEAEs), laboratory test results, physical examination, and vital signs., Dose Expansion Cohorts (Regimens A-C): Composite CR rate (CRMRD-, CR, CRh, CRp, CRi)., Dose Expansion Cohorts (Regimens A-C): Overall response rate (ORR) (CRMRD-, CR, CRh, CRp, CRi, MLFS, PR)., Dose Expansion Cohorts (Regimens A-C): Duration of remission (DOR)., Dose Expansion Cohorts (Regimens A-C): MRD levels using central flow cytometry–based testing., Dose Expansion Cohorts (Regimen D): MRD+ to MRD- conversion rate and relapse-free survival (RFS) in MRD+ Fit (Cohort D1) and MRD+ Unfit (Cohort D2) AML patients., Dose Expansion Cohorts (Regimen D): MRD levels using central flow cytometry–based testing.
Endpoint(s): Regimens A-C : Treatment-emergent adverse events (TEAEs) (Expansion Cohort)., Regimens A-C: IMGN632 PK parameters for intact antibody-drug conjugate (ADC), total antibody, and free payload (FGN849) include, but are not limited to,Cycle 1 and Cycle 3 maximum plasma concentration (Cmax), area under the time concentration curve (AUC), terminal half-life (t½), clearance (CL), volume of distribution at steady state (Vss), and time that Cmax occurs (tmax)., Regimens A-C: Blood concentration of azacitidine, venetoclax, and azacitidine + venetoclax measured before and after their administration., Regimens A-C: ADA response, Regimens A-C: MRD levels using central flow cytometry–based testing (Dose Escalation Phase)., Regimen D: Treatment-emergent adverse events (TEAEs)., Regimen D: IMGN632 PK parameters for intact ADC, total antibody, and free payload (FGN849) include, but are not limited to, Cycle 1 and Cycle 3 maximum plasma concentration (Cmax), area under the time concentration curve (AUC), terminal half-life (t½), clearance (CL), volume of distribution at steady state (Vss), and time that Cmax occurs (tmax)., Regimen D: ADA response.

Source: https://euclinicaltrials.eu/ctis-public/view/2024-514197-50-00